EU clinical trial 2023-503409-12-00: To Study the Safety and Pharmacokinetics of BLYG8824A in Patients with Locally Advanced or Metastatic Colorectal Cancers
Protocol code: GO41751
Sponsor: Genentech Inc. (Pharmaceutical company). Phase: Human Pharmacology (Phase I)- First administration to humans. Countries: Spain (ended).
Therapeutic area(s): Diseases [C] - Neoplasms [C04]
Gender: Female, Male. Age: 18-64 years, 65+ years. Enrolment: 24.
Status: Ended. Start date (EU): 2020-10-26. End date (EU): 2024-10-16. End date: 2024-10-17. Decision date: 2024-07-30. Results received: No. Last updated: 2024-07-30.

Condition(s): Locally Advanced or Metastatic Colorectal Cancers (mCRC)

Source: https://euclinicaltrials.eu/ctis-public/view/2023-503409-12-00